EU clinical trial 2025-521236-12-00: A mono-centre, non-comparative clinical trial on the inhibition of ovulation with LNG POP (Levonorgestrel tablet, 0.135 mg) during three 28-day cycles with continuous treatment and intentional intake errors
Protocol code: 1460lng24ct
Sponsor: SocraTec R&D Concepts in Drug Research and Development GmbH (Pharmaceutical company). Phase: Therapeutic exploratory (Phase II). Countries: Germany (ended).
Therapeutic area(s): Phenomena and Processes [G] - Reproductive and Urinary Physiological Phenomena [G08]
Gender: Female. Age: 18-64 years. Enrolment: 34.
Status: Ended. Start date (EU): 2025-07-02. End date (EU): 2026-04-14. Decision date: 2025-06-05. Results received: No. Last updated: 2025-07-22.
Decision dates by country: DE: 2025-06-26

Condition(s): Investigation of ovulation inhibition after intentional IMP intake errors for indication of contraception
Product: LNG-POP Levonorgestrel 0.135 mg Tablet

Primary endpoint: Ovulation under treatment (Ovulation during treatment is defined as a Hoogland-Skouby score (HSS) 5 or 6 in combination with fulfilment of Landgren criterion (P concentration >16.0 nmol/l during at least 5 consecutive days)

Source: https://euclinicaltrials.eu/ctis-public/view/2025-521236-12-00